EU clinical trial 2025-522854-37-00: A Phase 3, Randomized, Double-Blind, Placebo-Controlled, Multicenter Study to Assess the Efficacy and Safety of Panzyga for Prevention of Major Infections in Patients with Hypogammaglobulinemia and Autoimmune or Rheumatic Conditions Receiving Treatment with B-cell Depletion Therapy ("PROTECT")
Protocol code: NGAM-16
Sponsor: Octapharma Pharmazeutika Produktionsgesellschaft mbH (Pharmaceutical company). Phase: Therapeutic confirmatory (Phase III). Countries: Czechia (authorised, recruitment pending), Lithuania (authorised, recruitment pending), Greece (authorised, recruitment pending), Poland (authorised, recruitment pending), Germany (authorised, recruitment pending), Latvia (authorised, recruitment pending), Bulgaria (authorised, recruitment pending), Italy (authorised, recruitment pending).
Therapeutic area(s): Diseases [C] - Immune System Diseases [C20]
Gender: Female, Male. Age: 18-64 years, 65+ years. Enrolment: 215.
Status: Authorised, recruitment pending. Decision date: 2026-05-11. Results received: No. Last updated: 2026-06-29.
Decision dates by country: BG: 2026-05-14, CZ: 2026-05-11, IT: 2026-05-13, LV: 2026-05-13, PL: 2026-05-15, LT: 2026-05-13, DE: 2026-05-13, GR: 2026-05-11

Condition(s): Prevention of a Major infection in patients with Hypogammaglobulinemia and Autoimmune or Rheumatic Conditions receiving treatment with B-cell depletion therapy.
Product: Panzyga 100 mg/ml Infusionslösung, Isotone Kochsalz-Lösung 0,9 % Braun Infusionslösung

Primary endpoint: Occurrence of at least one major infection or death in patients with or without primary infection prophylaxis with Panzyga. Major infections will be recorded throughout the study along with the type and severity of infection and time to resolution. Each patient will be counted only once for the primary endpoint calculation. Each potential infection will be assessed by an Independent Adjudication Committee (IAC) consisting of clinical experts.
Endpoint(s): 1. Efficacy Endpoint: The time to first major infection (as assessed by the IAC) or death., 2. Safety Endpoint: Incidence of AEs, 3. Safety Endpoint: Changes from Baseline in physical examinations, and clinical laboratory parameters.

Source: https://euclinicaltrials.eu/ctis-public/view/2025-522854-37-00